EU clinical trial 2023-505615-21-00: A Phase 3, Randomized, Open-label Study to Evaluate Perioperative Enfortumab Vedotin Plus Pembrolizumab (MK-3475) Versus Neoadjuvant Gemcitabine and Cisplatin in Cisplatin-eligible Participants with Muscle-invasive Bladder Cancer (KEYNOTE-B15 / EV-304)
Protocol code: MK3475-B15
Sponsor: Merck Sharp & Dohme LLC (Pharmaceutical company). Phase: Therapeutic confirmatory (Phase III). Countries: Portugal (ongoing, recruitment ended), Bulgaria (ongoing, recruitment ended), Spain (ongoing, recruitment ended), Czechia (ongoing, recruitment ended), Romania (ongoing, recruitment ended), Hungary (ongoing, recruitment ended), Germany (ongoing, recruitment ended), Croatia (ongoing, recruitment ended), Italy (ongoing, recruitment ended), France (ongoing, recruitment ended), Poland (ongoing, recruitment ended), Greece (ongoing, recruitment ended).
Therapeutic area(s): Diseases [C] - Neoplasms [C04]
Gender: Female, Male. Age: 18-64 years, 65+ years. Enrolment: 445.
Status: Ongoing, recruitment ended. Start date (EU): 2021-04-28. Decision date: 2023-12-13. Results received: No. Last updated: 2026-07-10.
Decision dates by country: RO: 2023-12-15, IT: 2023-12-14, HR: 2023-12-18, BG: 2023-12-14, PL: 2024-01-16, HU: 2023-12-14, PT: 2023-12-13, FR: 2024-01-03, CZ: 2023-12-14, ES: 2023-12-14, DE: 2023-12-15, GR: 2024-01-26

Condition(s): Muscle Invasive Bladder Cancer
Product: KEYTRUDA 25 mg/mL concentrate for solution for infusion, GEMCITABINE, CISPLATIN, ENFORTUMAB VEDOTIN

Primary endpoint: Event-Free Survival (EFS)
Endpoint(s): Pathologic Complete Response (pCR) Rate, Overall Survival (OS), Disease Free Survival (DFS), Pathologic Downstaging (pDS) Rate, Number of Participants Who Experienced An Adverse Event (AE) (Arm A only), Number of Participants Who Discontinued Study Treatment Due to An AE (Arm A only), Change from Baseline in the European Organization for Research and Treatment of Cancer (EORTC)-Quality of Life Questionnaire-Core 30 (QLQ- C30) Global Health Status/Quality of Life (Items 29 and 30) Combined Score, Change from Baseline in EORTC QLQ-C30 Physical Functioning Scale, Change from Baseline in Urinary, Bowel and Sexual Domains per Bladder Cancer Index (BCI), Change from Baseline in EuroQoL-5 Dimensions, 5-level Questionnaire (EQ- 5D-5L) Visual Analogue Score (VAS), Time to Deterioration (TTD) in the EORTC-QLQ-C30 Global Health Status/Quality of Life (Items 29 and 30), TTD in the Physical Functioning Scale per EORTC QLQ-C30, TTD in the Role Functioning Scale per EORTC QLQ-C30, TTD in the Urinary, Bowel and Sexual Domains per BCI, TTD in the EQ-5D-5L VAS

Source: https://euclinicaltrials.eu/ctis-public/view/2023-505615-21-00